EU clinical trial 2023-504942-75-01: A Randomized, Double-Blind, Placebo-Controlled, Multi-Centre Study to Assess the Efficacy of PURETHAL Mites Mixture 50,000 AUeq/mL Subcutaneous Immunotherapy in Adult Subjects with Moderate to Severe Allergic Rhinitis/Rhinoconjunctivitis with or without Asthma Induced by House Dust Mite (HDM) Allergy
Protocol code: PM/0059
Sponsor: HAL Allergy B.V. (Pharmaceutical company). Phase: Therapeutic confirmatory (Phase III). Countries: Lithuania (ended), Germany (ended), Latvia (ended), Bulgaria (ended), Poland (ended), Austria (ended).
Therapeutic area(s): Diseases [C] - Immune System Diseases [C20]
Gender: Female, Male. Age: 18-64 years. Enrolment: 582.
Status: Ended. Start date (EU): 2024-08-22. End date (EU): 2026-03-30. Decision date: 2024-01-11. Results received: No. Last updated: 2026-04-29.
Decision dates by country: AT: 2024-09-22, LT: 2024-01-15, LV: 2024-05-15, PL: 2024-05-20, BG: 2024-05-20, DE: 2024-01-11

Condition(s): Moderate to Severe Allergic Rhinitis/Rhinoconjunctivitis with or without Asthma Induced by House Dust Mite (HDM) Allergy
Product: HAL Allergy Prick Test Gemeiner Beifuß, HAL Allergy Prick Test Positieve Controle 10 mg/ml, oplossing voor huidpriktest, HAL Allergy Prick Test Hundeepithelien, ALUMINIUM HYDROXIDE, MOMETASONE, PHENOL, HAL Allergy Prick Test Gräserpollen-Mischung, HAL Allergy Pricktest Negativkontrolle, Pricktestlösung, WATER FOR INJECTION, PRICK TEST Beifuss LETI, 30 HEP/ml Pricktestlösung., HAL Allergy Prick Test Hausstaubmilbe Dermatophagoides Pteronyssinus, HAL Allergy Prick Test Katzenepithelien, HAL Allergy Prick Test Aspergillus Fumigatus, PURETHAL Mites 50.000 AUeq/mL, SODIUM CHLORIDE, AZELASTINE, HAL Allergy Prick Test Frühblühende Bäume Mischung I, HAL Allergy Prick Test Hausstaubmilbe Dermatophagoides Farinae, LORATADINE, HAL Allergy Provo Spray, Provokationstestlösung, Nasenspray

Primary endpoint: Average daily TCRS during the last 8 weeks of treatment.
Endpoint(s): Average daily TNSS during the last 8 weeks of treatment., Average daily RMS during the last 8 weeks of treatment., Average daily TCCS during the last 8 weeks of treatment., Change from baseline in NPT (Lebel score) at the end of treatment., Change from baseline in IgE, IgG, IgG4 levels against D. pter and D. far at the end of treatment., RQLQ(S) at the end of treatment., Safety and tolerability during the entire treatment period assessed by treatment-related adverse events, local and systemic reactions., Safety of the treatment on asthma parameters assessed by asthma-related concomitant medication use, asthma related adverse events and lung function tests.

Source: https://euclinicaltrials.eu/ctis-public/view/2023-504942-75-01